EU clinical trial 2023-505756-21-00: Pan-tumor neoadjuvant basket study of immune check-point inhibition and novel IO combinations (NEOASIS)
Sponsor: Netherlands Cancer Institute (Laboratory/Research/Testing facility). Phase: Therapeutic exploratory (Phase II). Countries: Netherlands (ongoing, recruiting).
Therapeutic area(s): Diseases [C] - Neoplasms [C04]; Analytical, Diagnostic and Therapeutic Techniques and Equipment [E] - Therapeutics [E02]; Phenomena and Processes [G] - Immune system processes [G12]
Gender: Female, Male. Age: 18-64 years, 65+ years. Enrolment: 179.
Status: Ongoing, recruiting. Start date (EU): 2024-01-26. Decision date: 2023-10-24. Results received: No. Last updated: 2025-12-09.

Condition(s): dMMR tumors consisting of but not limited to; Colorectal cancer, oesophageal cancer, GEJ-cancer, Gastric cancer, Duodenal and small bowel cancer, endometrial cancer, breastcancer, prostate cancer and sarcoma. pMMR tumors constisting of but not limited to; gastric, gastro-esophageal junction (GEJ) and esophageal adenocarcinoma, triple-negative breast cancer
Product: BOTENSILIMAB, BALSTILIMAB

Primary endpoint: Major pathologic response (MPR) rate, defined as <10% residual viable tumor (RVT) in the resection specimen. If after neoadjuvant therapy in situ carcinoma or equivalent non-invasive residual tissue is found upon pathologic assessment, this residual tumor will not be considered in the calculation of RVT. In case of complete resolution of invasive tumor cells and only in situ or equivalent non-invasive tissue (according to tumor type) these tumor will be considered to have a pCR to treatment., Primary endpoint dMMR rectal cancer OP cohort: Primary endpoint is the proportion of patients with either complete or near-complete response at the second clinical response assessment or pathologic evaluation at surgery, whichever comes first
Endpoint(s): Pathologic complete response (pCR) defined as no RVT in the primary tumor and locoregional lymph nodes; partial pathologic response (≤50% RVT) and no pathologic response (>50% RVT), Event-free survival defined as time from registration to the date of local, regional or distant disease progression, local, regional or distant recurrence, or death from any cause. Disease progression is defined as a relative increase in sum of diameters of primary tumor of ≥20%, with an absolute increase of ≥5mm. Disease progression during neoadjuvant treatment is considered an event, regardless of whether this leads to a change in treatment. In situ carcinoma and second primary are not events, DFS: disease free survival defined as the time from surgery to disease recurrence during follow-up which consists of either local or regional recurrence, metastatic disease or disease-related death. In situ carcinoma and second primary cancers are not considered events., OS: overall survival defined as time from registration until death from any cause., Radiological response according to RECIST 1.1, dMMR rectal cancer organ preservation cohort only: Clinical complete and near-complete responses without additional standard of care (SCRT/CRT), dMMR rectal cancer organ preservation cohort only: organ preservation at 1 year: organ preservation is considered to have failed, dMMR rectal cander organ preservation cohort only: Proportion of patients undergoing transanal local excision to achieve organ preservation in case of a near complete response, dMMR rectal cander organ preservation cohort only: Time to event of organ loss assessed for patients who prefer organ preservation; defined as the length of time from the start date of trial treatment until TME surgery, dMMR rectal cancer organ preservation cohort only: Distant metastasis-free survival at 24 and 36 months, dMMR rectal cancer organ preservation cohort only: Locoregional regrowth-free survival at 24 and 36 months

Source: https://euclinicaltrials.eu/ctis-public/view/2023-505756-21-00